EU clinical trial 2024-516864-27-00: CardioPulmonary resuscitation with Argon (CPAr) trial
Protocol code: IRFMN 7557/8154
Sponsor: Istituto Di Ricerche Farmacologiche Mario Negri (Laboratory/Research/Testing facility). Phase: Therapeutic exploratory (Phase II). Countries: Italy (authorised, recruitment pending).
Therapeutic area(s): Diseases [C] - Cardiovascular Diseases [C14]
Gender: Female, Male. Age: 18-64 years, 65+ years. Enrolment: 120.
Status: Authorised, recruitment pending. Decision date: 2024-10-07. Results received: No. Last updated: 2026-03-16.

Condition(s): Cardiac arrest
Product: Argon/Oxygen mixture, OXYGEN

Primary endpoint: 48 h Serum Neuron Specific Enolase (NSE) concentration for evaluation of Ar activity on neuronal preservation.
Endpoint(s): hs-cTnT plasma concentration for evaluation of Ar activity on myocardial preservation;, Brain imaging (MRI with DWI and DTI, in patients that remain comatose), for evaluation of Ar activity on neuronal preservation;, Multiorgan function (circulating biomarkers);, Survival and CPC score up to 6 months, for evaluation of functional outcome.

Source: https://euclinicaltrials.eu/ctis-public/view/2024-516864-27-00